EU clinical trial 2024-516708-40-00: SENtinel lymph node mapping with GAllium-68-tilmanocept PET/CT in high/high- intermediate risk endometrial cancer: a proof-of-concept study
Sponsor: Universitair Medisch Centrum Utrecht (Hospital/Clinic/Other health care facility). Phase: Therapeutic confirmatory (Phase III). Countries: Netherlands (ended).
Therapeutic area(s): Diseases [C] - Neoplasms [C04]
Gender: Female. Age: 18-64 years, 65+ years. Enrolment: 10.
Status: Ended. Start date (EU): 2024-11-15. End date (EU): 2026-04-09. Decision date: 2024-11-15. Results received: No. Last updated: 2024-11-15.

Condition(s): Endometrial cancer, uterine cancer
Product: GALLIUM (68GA) CHLORIDE, TILMANOCEPT

Primary endpoint: Primary endpoint is the feasibility of the SLN procedure using 68-Ga tilmanocept PET/CT in patients with high/high-intermediate riskendometrial cancer. The feasibility is assessed by the SLN detection rate of 68Ga-tilmanocept PET/CT. The SLN detection rate of PET/CT is defined as the detection of a PET-avid node.
Endpoint(s): - To investigate the correlation between SLN detection rate and anatomical location of SLNs with preoperative 68Ga-tilmanoceptPET/CT versus intraoperative ICG with NIR fluorescence; - To assess pathological status of the SLNs: tumour negative, macrometastasis (diameter >2.0 mm), micrometastasis (diameterbetween 0.2 and 2.0 mm) or isolated tumour cells (diameter <0.2 mm or individual tumour cells);, Adverse events related to SLN mapping with 68Ga-tilmanocept PET/CT up to one hour post-PET/CT (graded by CommonTerminology Criteria for Adverse Events (CTCAE) v5.0).

Source: https://euclinicaltrials.eu/ctis-public/view/2024-516708-40-00